EU clinical trial 2025-522435-33-00: A MULTICENTER, RANDOMIZED, OPEN-LABEL, PHASE III CLINICAL TRIAL TO EVALUATE THE EFFICACY, SAFETY, PHARMACOKINETICS AND PHARMACODYNAMICS OF NXT007 PROPHYLAXIS VERSUS EMICIZUMAB PROPHYLAXIS IN PEOPLE WITH HEMOPHILIA A
Protocol code: BO45887
Sponsor: F. Hoffmann-La Roche AG (Pharmaceutical company). Phase: Therapeutic confirmatory (Phase III). Countries: Hungary (ongoing, recruiting), Spain (ongoing, recruiting), Ireland (authorised, recruitment pending), Poland (authorised, recruitment pending), Austria (authorised, recruitment pending), Germany (authorised, recruiting), Denmark (authorised, recruiting), Belgium (ongoing, recruiting), Netherlands (ongoing, recruiting), Italy (ongoing, recruiting), France (authorised, recruiting).
Therapeutic area(s): Diseases [C] - Hemic and Lymphatic Diseases [C15]; Not possible to specify; Diseases [C] - Congenital, Hereditary, and Neonatal Diseases and Abnormalities [C16]
Gender: Female, Male. Age: 0-17 years, 18-64 years, 65+ years. Enrolment: 124.
Start date (EU): 2026-06-17. Decision date: 2026-06-01. Results received: No. Last updated: 2026-06-08.
Decision dates by country: BE: 2026-06-02, DK: 2026-06-02, FR: 2026-06-01, DE: 2026-06-03, HU: 2026-06-04, IT: 2026-06-04, ES: 2026-06-05, NL: 2026-06-05, PL: 2026-06-05, AT: 2026-06-01, IE: 2026-06-05

Condition(s): Hemophilia A
Product: NXT007, NXT007, NXT007, Hemlibra 150 mg/mL solution for injection, NXT007

Primary endpoint: Annualized number of treated bleeds (ABR) over the main study treatment period from the Month 2 visit until the clinical cutoff date (CCOD)
Endpoint(s): Annualized number of treated bleeds (ABR) over the main study treatment period from the Month 2 visit until the clinical cutoff date (CCOD), ABR over the main study treatment period from the Month 2 visit until the CCOD for: –All bleeds (treated and untreated) –Treated spontaneous bleeds – Treated joints bleeds, Quality of Life domain score in adult version at Month 8 visit, Annualized number of treated target joint bleeds (ABR) over time in the main study treatment period, Proportion of participants with zero treated bleeds in the main study treatment period, Number of injections and dose (per body weight) per bleed of coagulation factors or BPA administrated to treat a bleed, Annualized FVIII/BPA injection rate and annualized FVIII/BPA consumption (excluding prior to procedures or surgeries), Quality of Life domain score in adult and adolescent version at Month 8 visit, Change from baseline in preoccupation, social activity impact and recreational activity impact domain scores, Physical impact domain score at specified timepoint, Incidence and severity of adverse events, with severity determined according to National Cancer Institute Common Terminology Criteria for Adverse Events, Version 5.0 (NCI CTCAE v5.0), Incidence and severity of thromboembolic events and thrombotic microangiopathy, Incidence and severity of injection-site reactions, Incidence of adverse events leading to discontinuation of assigned study treatment, Incidence of severe hypersensitivity, anaphylaxis, or anaphylactoid reactions, Plasma concentration of NXT007 at specified timepoints, Prevalence of anti-NXT007 antibodies (ADAs) at baseline and incidence of ADAs during the study, Incidence of neutralizing ADAs

Source: https://euclinicaltrials.eu/ctis-public/view/2025-522435-33-00